EU clinical trial 2024-511935-86-00: Pasireotide as Maintenance Treatment with monthly deep intramuscular injection in SSTR2/3/5-Expressing Synovial Sarcoma and Desmoplastic Small Round Cell Tumor (PAMSARC)
Protocol code: HEROES-AYA I
Sponsor: Universitaetsklinikum Heidelberg AöR (Hospital/Clinic/Other health care facility). Phase: Therapeutic exploratory (Phase II). Countries: Germany (ongoing, recruiting).
Therapeutic area(s): Diseases [C] - Neoplasms [C04]
Gender: Female, Male. Age: 0-17 years, 18-64 years. Enrolment: 28.
Status: Ongoing, recruiting. Start date (EU): 2024-12-18. Decision date: 2024-11-12. Results received: No. Last updated: 2026-08-03.

Condition(s): Locally advanced or metastatic synovial sarcoma ICD-O3, 9040/3, 9041/3, 9042/3, 9043/3 Locally advanced or metastatic desmoplastic small round cell tumor ICD-O3, 8806/3
Product: PASIREOTIDE, PASIREOTIDE

Primary endpoint: Progression free survival (PFS), measured from study registration to radiologically confirmed disease progression according to Response Evaluation Criteria In Solid Tumors (RECIST) version 1.1, or death from any cause, whichever occurs first (censoring of patients without an event at date of last follow-up)
Endpoint(s): Overall survival (OS), measured from study registration to death from any cause (censoring of patients without an event at date of last follow-up)

Source: https://euclinicaltrials.eu/ctis-public/view/2024-511935-86-00